EU clinical trial 2025-521330-29-00: Ketamine maintenance treatment for depression: A multicenter open-label randomized controlled trial
Protocol code: PreKET
Sponsor: Ostfold Hospital Trust (Hospital/Clinic/Other health care facility). Phase: Therapeutic exploratory (Phase II). Countries: Norway (authorised, recruitment pending).
Therapeutic area(s): Analytical, Diagnostic and Therapeutic Techniques and Equipment [E] - Therapeutics [E02]; Psychiatry and Psychology [F] - Mental Disorders [F03]; Psychiatry and Psychology [F] - Psychological Phenomena [F02]
Gender: Female, Male. Age: 18-64 years, 65+ years. Enrolment: 230.
Status: Authorised, recruitment pending. Decision date: 2025-11-05. Results received: No. Last updated: 2026-06-01.

Condition(s): Major Depression Disorder (MDD)
Product: KETAMINE HYDROCHLORIDE

Primary endpoint: • Time-to-relapse after induction phase assessed by clinician rated MADRS between all 3 treatment arms, • Time-to-relapse after the last ketamine infusion assessed by clinician rated MADRS between all three treatment arms
Endpoint(s): • Assess frequency, severity and duration of ARs/SARs through clinical interview, observation, SCI-2 SF, DLCQ and PreKET symptom checklist, patient chart review, spontaneously reported adverse events from signing the ICF to Final visit.

Source: https://euclinicaltrials.eu/ctis-public/view/2025-521330-29-00